EU clinical trial 2024-516471-33-00: (22419) A randomized, double-blind, placebo-controlled, parallel group Phase 2a study with an extension phase to evaluate the efficacy and safety of BAY 3401016 in participants aged 18 to 45 with Alport syndrome
Protocol code: 22419
Sponsor: Bayer AG (Pharmaceutical company). Phase: Therapeutic exploratory (Phase II). Countries: Spain (ongoing, recruiting), Italy (ongoing, recruiting), Poland (ongoing, recruiting), Czechia (ongoing, recruiting), Germany (ongoing, recruiting), Portugal (ongoing, recruiting), France (ongoing, recruiting).
Therapeutic area(s): Diseases [C] - Congenital, Hereditary, and Neonatal Diseases and Abnormalities [C16]
Gender: Female, Male. Age: 18-64 years. Enrolment: 31.
Status: Ongoing, recruiting. Start date (EU): 2026-01-19. Decision date: 2025-12-05. Results received: No. Last updated: 2026-04-02.
Decision dates by country: CZ: 2025-12-09, DE: 2025-12-10, ES: 2025-12-10, PL: 2025-12-09, IT: 2025-12-09, FR: 2026-01-06, PT: 2026-01-09

Condition(s): Alport Syndrome, Chronic kidney disease
Product: Placebo to BAY 3401016, BAY 3401016

Primary endpoint: Mean UACR ratio to baseline averaged over 16, 20 and 24 weeks of treatment
Endpoint(s): Number of participants with TEAEs and TESAEs

Source: https://euclinicaltrials.eu/ctis-public/view/2024-516471-33-00